EU clinical trial 2022-500256-37-00: A Phase 3 International, Multicenter, Open-label Study to Evaluate the Safety and Immunogenicity of 9vHPV Vaccine Administered as 2-dose Regimen with Extended Dosing Intervals in 9- to 14-Year Old Boys and Girls Compared with a Standard 3-dose Regimen in 16- to 26-Year Old Women
Protocol code: V503-069
Sponsor: Merck Sharp & Dohme LLC (Pharmaceutical company). Phase: Therapeutic confirmatory (Phase III). Countries: Poland (ongoing, recruitment ended).
Therapeutic area(s): Phenomena and Processes [G] - Immune system processes [G12]
Gender: Female, Male. Age: 0-17 years, 18-64 years. Enrolment: 80.
Status: Ongoing, recruitment ended. Start date (EU): 2021-04-08. Decision date: 2022-09-09. Results received: No. Last updated: 2025-09-17.

Condition(s): Prevention of persistent anogenital HPV infection and disease caused by HPV Types 6, 11, 16, 18, 31, 33, 45, 52, and 58
Product: Gardasil 9 suspension for injection in a pre-filled syringe Human Papillomavirus 9-valent Vaccine (Recombinant, adsorbed), Gardasil 9 suspension for injection in a pre-filled syringe Human Papillomavirus 9-valent Vaccine (Recombinant, adsorbed), Gardasil 9 suspension for injection Human Papillomavirus 9-valent Vaccine (Recombinant, adsorbed)

Primary endpoint: Geometric Mean Titers of Anti-Human Papilloma Virus Types 6, 11, 16, 18, 31, 33, 45, 52, and 58 as Measured by Competitive Luminex Immunoassay at 4 Weeks Post Last Vaccination, Percentage of Participants With at Least 1 Solicited Injection-site Adverse Event, Percentage of Participants With at Least 1 Systemic Adverse Event, Percentage of Participants With at Least 1 Serious Vaccine-Related Adverse Event
Endpoint(s): Percentage of Participants (Cohorts 1 to 5) Who Are Seropositive for HPV Types 6, 11, 16, 18, 31, 33, 45, 52, and 58 at 4 Weeks Post Last Vaccination, Geometric Mean Titers (Cohorts 1 to 5) of Anti-HPV Types 6, 11, 16, 18, 31, 33, 45, 52, and 58 at 12 Months Post Last Vaccination, Percentage of Participants (Cohorts 1 to 5) Who Are Seropositive for HPV Types 6, 11, 16, 18, 31, 33, 45, 52, and 58 at 12 Months Post Last Vaccination, Geometric Mean Titers (Cohorts 1 to 5) of Anti-HPV Types 6, 11, 16, 18, 31, 33, 45, 52, and 58 at 24 Months Post Last Vaccination, Percentage of Participants (Cohorts 1 to 5) Who Are Seropositive for HPV Types 6, 11, 16, 18, 31, 33, 45, 52, and 58 at 24 Months Post Last Vaccination, Geometric Mean Titers (Cohorts 1 to 5) of Anti-HPV Types 6, 11, 16, 18, 31, 33, 45, 52, and 58 at 36 Months Post Last Vaccination, Percentage of Participants (Cohorts 1 to 5) Who Are Seropositive for HPV Types 6, 11, 16, 18, 31, 33, 45, 52, and 58 at 36 Months Post Last Vaccination

Source: https://euclinicaltrials.eu/ctis-public/view/2022-500256-37-00